EU clinical trial 2024-516721-31-00: OPEN-LABEL SAFETY STUDY OF A 1-YEAR 20MG DOSE REGIMEN OF TASIMELTEON FOR THE TREATMENT OF NON-24-HOUR SLEEP-WAKE DISORDER (N24HSWD) IN BLIND INDIVIDUALS WITH NO LIGHT PERCEPTION
Protocol code: VP-VEC-162-3202
Sponsor: Vanda Pharmaceuticals Inc. (Pharmaceutical company). Phase: Therapeutic confirmatory (Phase III). Countries: France (ongoing, recruitment ended).
Therapeutic area(s): Diseases [C] - Nervous System Diseases [C10]
Gender: Female, Male. Age: 18-64 years, 65+ years. Enrolment: 140.
Status: Ongoing, recruitment ended. Start date (EU): 2024-12-03. Decision date: 2024-12-03. Results received: No. Last updated: 2026-01-23.

Condition(s): Non-24 Hour Sleep-Wake Disorder
Product: TASIMELTEON, HETLIOZ 20 mg hard capsules

Primary endpoint: Adverse events (AEs) including suicidal ideation or behavior, changes in vital signs, clinical laboratory evaluations, electrocardiograms (ECGs) and physical exam findings during treatment.
Endpoint(s): Patient Global Impression-Change (PGI-C) for nighttime sleep., Patient Global Impression-Change (PGI-C) for daytime naps., Clinical Global Impression-Change (CGI-C).

Source: https://euclinicaltrials.eu/ctis-public/view/2024-516721-31-00